EU clinical trial 2024-510949-34-00: YF_PROTECT: Prophylactic Treatment with Sofosbuvir for Yellow fever Exemption Circumstances and Travel
Sponsor: Leids Universitair Medisch Centrum (LUMC) (Hospital/Clinic/Other health care facility). Phase: Therapeutic use (Phase IV). Countries: Netherlands (ended).
Therapeutic area(s): Diseases [C] - Virus Diseases [C02]
Gender: Female, Male. Age: 18-64 years. Enrolment: 30.
Status: Ended. Start date (EU): 2024-09-11. End date (EU): 2025-04-02. Decision date: 2024-08-22. Results received: Yes. Last updated: 2024-12-13.

Condition(s): Healthy volunteers
Product: Sovaldi 400 mg film-coated tablets

Primary endpoint: viremia (YF17D virus in plasma) at any time (yes/no), and/ or viruria (YF17D in urine) at any time (yes/no), and/ or neutralizing antibodies on D28 after vaccination (yes/no)
Endpoint(s): Adverse events of sofosbuvir (diary with an SmPC based symptom questionnaire and reporting of any unsolicited adverse events), Increase in ALT and bilirubin, and decrease in Hb levels on day 5* and 28 after vaccination compared to day 0 in the sofosbuvir treatment group. * For group B this will be done on day 2, do make sure the sample is taken within reasonable time after sofosbuvir use, Differences in ALT, bilirubin and blood count (i.e., haemoglobin, thrombocytes, leukocyte differentiation) between the sofosbuvir treatment and no treatment group, Exploratory endpoint: Plasma is stored for determination of sofosbuvir concentration, which will only be measured when viremia or viruria or yellow fever neutralizing antibodies are not absent/decreased in participants in the sofosbuvir treatment group

Source: https://euclinicaltrials.eu/ctis-public/view/2024-510949-34-00